EU clinical trial 2022-502954-15-00: A 26-Week, Randomized, Double-Blind, Placebo-Controlled, Multi-center Study to Evaluate the Efficacy, Safety, and Tolerability of Axatilimab in Subjects with Idiopathic Pulmonary Fibrosis (IPF)
Protocol code: SNDX-6352-0506
Sponsor: Syndax Pharmaceuticals Inc. (Pharmaceutical company). Phase: Therapeutic exploratory (Phase II). Countries: Italy (ongoing, recruitment ended), Spain (ongoing, recruitment ended), Czechia (ended), Poland (ongoing, recruitment ended), France (ongoing, recruitment ended), Germany (ended), Belgium (ended), Romania (ended).
Therapeutic area(s): Diseases [C] - Respiratory Tract Diseases [C08]
Gender: Female, Male. Age: 18-64 years, 65+ years. Enrolment: 141.
Start date (EU): 2024-06-21. Decision date: 2024-04-05. Results received: No. Last updated: 2026-07-15.
Decision dates by country: BE: 2024-08-02, CZ: 2024-08-02, DE: 2024-07-26, FR: 2024-08-12, IT: 2024-04-09, RO: 2025-09-01, PL: 2024-08-06, ES: 2024-05-03

Condition(s): Idiopathic pulmonary fibrosis
Product: AXATILIMAB, Placebo

Primary endpoint: The annualized rate of decline in morning pre dose trough forced vital capacity (FVC) (mL) over 26 weeks
Endpoint(s): Time to disease progression. Disease progression is defined as absolute FVC percent predicted decline of ≥10%, or occurrence of lung transplant or all-cause death prior to Week 26., The annualized rate of decline in FVC percent predicted over 26 weeks., Change in St. George’s Respiratory Questionnaire (SGRQ) from baseline to Week 26., The mean change in diffusion capacity for carbon monoxide (DLCO % of predicted, corrected for hemoglobin) from baseline to Week 26.

Source: https://euclinicaltrials.eu/ctis-public/view/2022-502954-15-00